EU clinical trial 2024-513124-41-00: Influencing Progression of Airway Disease in Primary Antibody Deficiency
Protocol code: NL79088.041.21
Sponsor: Universitair Medisch Centrum Utrecht (Hospital/Clinic/Other health care facility). Phase: Therapeutic confirmatory (Phase III). Countries: Netherlands (ended).
Therapeutic area(s): Diseases [C] - Immune System Diseases [C20]
Gender: Female, Male. Age: 0-17 years, 18-64 years. Enrolment: 100.
Status: Ended. Start date (EU): 2024-07-12. End date (EU): 2026-03-31. Decision date: 2024-07-12. Results received: No. Last updated: 2026-03-18.

Condition(s): Primary antibody deficiency: - Unclassified antibody deficiency (unPAD); - IgA deficiency; - Specific polysaccharide antibody deficiency (SPAD); - IgG subclass deficiency (IgSD); - Common variable immunodeficiency (CVID); - Agammaglobulinemia (X-linked or otherwise)
Product: Privigen 100 mg/ml solution for infusion, Gammanorm, 165 mg/ml, oplossing voor injectie, Octagam 10%, oplossing voor infusie, Nanogam 100 mg/ml oplossing voor infusie, Hizentra 200 mg/ml solution for subcutaneous injection, HyQvia 100 mg/ml solution for infusion for subcutaneous use, Cuvitru 200 mg/ml oplossing voor subcutane injectie, KIOVIG 100 mg/ml solution for infusion, CUTAQUIG 165 mg/mL, solution injectable, GAMMAGARD S/D 5,0 g, poeder en oplosmiddel voor oplossing voor infusie.

Primary endpoint: Difference in mean AD and ILD scores (as measured with CT scanning) between t=0 and t=2 years in patients with standard vs higher Ig replacement therapy dosing.
Endpoint(s): Number of upper- and lower respiratory tract infections before onset of study and during study, i.e.: Sino pulmonary disease, otitis, pneumonia, collected by study CRF's., Pulmonary symptoms will be evaluated on a daily basis (during two periods of 2 months) using a diary that can be directly entered in Castor., Days missed from school and work due to infections, measured by the PCQ (productivity cost questionnaire) instrument., Quality of life, measured with the EQ-5D questionnaire, Ig dosing and IgG trough levels in intervention and in control group, Total health costs (consisting of costs for health care professional visits, medication, hospitalizations, imaging and biochemical investigations) in intervention and control group, collected from electronic patient files., Immunological laboratory phenotype, collected from electronic patient files., Adverse events: reporting and monitoring of patients and Adverse Events (AEs), Serious Adverse Events (SAEs) and Suspected Unexpected Serious Adverse Reaction (SUSARs) will be done by an independent monitor.

Source: https://euclinicaltrials.eu/ctis-public/view/2024-513124-41-00